EU clinical trial 2024-519670-39-00: Examining the effects of intravenous oxytocin infusion on peripheral sensory afferents using microneurography technique in healthy volunteers: a triple-blind, randomized, placebo-controlled trial
Protocol code: PAINOXY
Sponsor: Linkopings Universitet (Educational Institution). Phase: Human Pharmacology (Phase I)- Other. Countries: Sweden (ongoing, recruiting).
Therapeutic area(s): Diseases [C] - Nervous System Diseases [C10]
Gender: Female, Male. Age: 18-64 years. Enrolment: 60.
Status: Ongoing, recruiting. Start date (EU): 2025-10-13. Decision date: 2025-04-14. Results received: No. Last updated: 2025-04-14.

Condition(s): Healthy participants
Product: Oxytocin Grindeks 8,3 mikrogram/ml injektions-/infusionsvätska, lösning

Primary endpoint: • Single afferent neuronal response (i.e., number of spike) of afferents to test filaments (1000 and 20 mN after heat-inflammation in AHTMRs and in LTMRs, respectively (see details under 10.2.1).
Endpoint(s): • Psychophysics I: Psychophysical quantification of touch pleasantness, • Psychophysics I: Psychophysical quantification of inflammation, • Measuring the scores on cognitive performances (information processing speed accuracy, scores on learning and memory, and maximum scores and total scores on verbal WM) contrasting oxytocin with saline infusion

Source: https://euclinicaltrials.eu/ctis-public/view/2024-519670-39-00